EU clinical trial 2025-521029-34-00: A Phase 2, Randomized, Controlled, Open Label, Adaptive Dose Design, Proof-of-Concept Study to Evaluate the Efficacy, Safety, and Pharmacokinetics of Two Different Dwell Times of VS-01 on Top of Standard of Care versus Standard of Care Alone in Patients with Overt Hepatic Encephalopathy
Protocol code: VS01_P2_24_2
Sponsor: Versantis AG (Pharmaceutical company). Phase: Therapeutic exploratory (Phase II). Countries: Germany (ended), Belgium (ended), Spain (ended), France (ended).
Therapeutic area(s): Phenomena and Processes [G] - Metabolism [G03]
Gender: Female, Male. Age: 18-64 years, 65+ years. Enrolment: 30.
Status: Ended. Start date (EU): 2025-09-18. End date (EU): 2025-09-19. End date: 2025-12-19. Decision date: 2025-08-19. Results received: No. Last updated: 2025-08-21.
Decision dates by country: BE: 2025-08-21, FR: 2025-08-19, DE: 2025-08-19, ES: 2025-08-20

Condition(s): Patients with overt hepatic encephalopathy (OHE) and acute decompensation (AD) of liver cirrhosis or acute-on chronic liver failure (ACLF) grade 1
Product: VS-01

Primary endpoint: Time to improvement of OHE as assessed by HEGI. Improvement is defined as: a) A reduction of HE grades 4 or 3 to grade ≤2, or b) A reduction of HE grade 2 to grade <2.
Endpoint(s): Safety and tolerability defined as: a) The incidence and severity (National Cancer Institute Common Terminology Criteria for Adverse Events [NCI CTCAE] v5.0 grade) of treatment-emergent adverse events (TEAEs) including serious adverse events (SAEs), comprising the evaluation of vital signs, ECG parameters, and laboratory parameters., PK/PD: a) PK (for active treatment arms): blood and peritoneal fluid concentration-time profile of BL-corrected citric acid and lipids in patients treated with VS-01. b) PD (for all arms): change from BL in fasting blood and peritoneal fluid ammonia levels.

Source: https://euclinicaltrials.eu/ctis-public/view/2025-521029-34-00